EU clinical trial 2024-515656-20-00: J1G-MC-LAKI: A Study of Remternetug Versus Placebo in Early Alzheimer’s Disease Participants at Risk for Cognitive and Functional Decline
Protocol code: J1G-MC-LAKI
Sponsor: Eli Lilly & Co. (Pharmaceutical company). Phase: Therapeutic confirmatory (Phase III). Countries: Spain (ongoing, recruitment ended).
Therapeutic area(s): Diseases [C] - Nervous System Diseases [C10]
Gender: Female, Male. Age: 65+ years. Enrolment: 43.
Status: Ongoing, recruitment ended. Start date (EU): 2025-04-15. Decision date: 2025-03-11. Results received: No. Last updated: 2026-05-04.
Decision dates by country: ES: 2025-04-11

Condition(s): Alzheimer’s Disease
Product: Remternetug, Placebo to match LY

Primary endpoint: Time to Clinically Meaningful Progression as Measured by Clinical Dementia Rate (CDR). CDR is a clinician-rated scale that provides an overall assessment of the participant's stage and degree of impairment across the continuum of early Alzheimer's Disease (AD).

Source: https://euclinicaltrials.eu/ctis-public/view/2024-515656-20-00